EU clinical trial 2025-521976-80-00: A Phase 2, Open-label Study of JNJ-79635322 in Participants with Relapsed or Refractory Multiple Myeloma (RRMM) who Have Received at least 3 Prior Lines of Therapy Including a PI, an IMiD, and an Anti-CD38 Antibody
Protocol code: 79635322MMY2001
Sponsor: Janssen Cilag International (Pharmaceutical company). Phase: Therapeutic exploratory (Phase II). Countries: Poland (ongoing, recruiting), Italy (ongoing, recruiting).
Therapeutic area(s): Diseases [C] - Neoplasms [C04]
Gender: Female, Male. Age: 18-64 years, 65+ years. Enrolment: 54.
Status: Ongoing, recruiting. Start date (EU): 2026-05-28. Decision date: 2026-05-14. Results received: No. Last updated: 2026-05-25.
Decision dates by country: IT: 2026-05-14, PL: 2026-05-25

Condition(s): Relapsed or Refractory Multiple Myeloma (RRMM)
Product: JNJ-79635322, JNJ-79635322

Primary endpoint: Overall response rate

Source: https://euclinicaltrials.eu/ctis-public/view/2025-521976-80-00